EU clinical trial 2025-522935-32-00: Food effect and single- and multiple-ascending dose clinical trial of DF2755A in healthy participants
Protocol code: DF2755A-HV-101
Sponsor: Dompe' Farmaceutici S.p.A. (Pharmaceutical company). Phase: Human Pharmacology (Phase I)- Other. Countries: Netherlands (authorised, recruitment pending).
Therapeutic area(s): Diseases [C] - Pathological Conditions, Signs and Symptoms [C23]; Diseases [C] - Female Urogenital Diseases and Pregnancy Complications [C13]; Diseases [C] - Male Urogenital Diseases [C12]
Gender: Female, Male. Age: 18-64 years. Enrolment: 56.
Status: Authorised, recruitment pending. Decision date: 2025-10-17. Results received: No. Last updated: 2025-10-17.

Condition(s): interstitial cystitis/bladder pain syndrome

Source: https://euclinicaltrials.eu/ctis-public/view/2025-522935-32-00